EU clinical trial 2022-502695-23-00: ELVN-002 in Solid Tumors with a HER2 Genetic Alteration
Protocol code: ELVN-002-001
Sponsor: Enliven Therapeutics Inc. (Pharmaceutical company). Phase: Human Pharmacology (Phase I)- First administration to humans. Countries: Spain (ended), Italy (ended), France (ended).
Therapeutic area(s): Diseases [C] - Neoplasms [C04]
Gender: Female, Male. Age: 18-64 years, 65+ years. Enrolment: 120.
Status: Ended. Start date (EU): 2023-09-27. End date (EU): 2026-06-30. End date: 2026-07-01. Decision date: 2023-05-29. Results received: No. Last updated: 2025-06-06.
Decision dates by country: ES: 2023-05-29, IT: 2023-06-05, FR: 2023-06-05

Condition(s): Phase 1a Monotherapy Dose Escalation and Exploration: HER2 mutant, HER2 amplified or HER2 positive solid tumor; Phase 1a Dose Escalation Combination with T-DXd: HER2 mutant Non-small Cell Lung Cancer; Phase 1a Dose Escalation Combination with T-DM1: HER2 positive Metastatic Breast Cancer; Phase 1b Monotherapy Dose Expansion: HER2 mutant Non-small Cell Lung Cancer

Source: https://euclinicaltrials.eu/ctis-public/view/2022-502695-23-00